EU clinical trial 2023-508510-42-00: C3391003 - A PHASE 3, MULTICENTER, RANDOMIZED, DOUBLE-BLIND, PLACEBO-CONTROLLED STUDY TO EVALUATE THE SAFETY AND EFFICACY OF PF-06939926 FOR THE TREATMENT OF DUCHENNE MUSCULAR DYSTROPHY
Protocol code: C3391003
Sponsor: Pfizer Inc. (Pharmaceutical company). Phase: Therapeutic confirmatory (Phase III). Countries: Italy (ongoing, recruitment ended), Germany (ongoing, recruitment ended), Belgium (ongoing, recruitment ended), France (ongoing, recruitment ended), Spain (ongoing, recruitment ended).
Therapeutic area(s): Diseases [C] - Musculoskeletal Diseases [C05]
Gender: Male. Age: 0-17 years. Enrolment: 48.
Status: Ongoing, recruitment ended. Start date (EU): 2025-03-24. Decision date: 2024-07-10. Results received: No. Last updated: 2026-02-20.
Decision dates by country: FR: 2024-08-21, BE: 2024-07-12, ES: 2024-07-15, IT: 2024-08-12, DE: 2024-07-10

Condition(s): DUCHENNE MUSCULAR DYSTROPHY (DMD)
Product: Fordadistrogene Movaparvovec, ECULIZUMAB, Placebo for PF-06939926

Primary endpoint: Change from Baseline at Week 52 in the NSAA total score.
Endpoint(s): Change from Baseline in percent normal mini-dystrophin expression level in biceps brachii muscle biopsies at Day 360 using a liquid chromatography mass spectrometry (LC-MS) assay., Change from Baseline in percent of muscle fibers expressing mini-dystrophin in biceps brachii muscle biopsies at Day 360 as assessed by immunofluorescence., Change from Baseline at Week 52 in serum CK concentration., Number of skills gained at Week 52 based on the individual items of the NSAA., Number of skills either improved or maintained at Week 52 based on the individual items of the NSAA., Change from Baseline at Week 52 in the 10 meter run/walk velocity., Change from Baseline at Week 52 in the rise from floor velocity., Change from Baseline at Week 52 in the Modified Pediatric Outcomes Data Collection Instrument (PODCI): Transfer and Basic Mobility Core Scale (Pediatric Parent)., Change from Baseline at Week 52 in the Modified PODCI: Sports and Physical Functioning Core Scale (Pediatric Parent).

Source: https://euclinicaltrials.eu/ctis-public/view/2023-508510-42-00